EU clinical trial 2024-518917-24-00: Improvement of Quality of Life by Cannabinoids in Oncologic Patients (BELCANTO)
Protocol code: BELCANTO
Sponsor: Universitaetsklinikum Schleswig-Holstein AöR (Hospital/Clinic/Other health care facility). Phase: Therapeutic exploratory (Phase II). Countries: Germany (ended).
Therapeutic area(s): Not possible to specify; Diseases [C] - Pathological Conditions, Signs and Symptoms [C23]
Gender: Female, Male. Age: 18-64 years. Enrolment: 170.
Status: Ended. Start date (EU): 2023-11-08. End date (EU): 2026-02-19. Decision date: 2024-11-04. Results received: No. Last updated: 2025-10-29.

Condition(s): oncology, palliative care, quality of life
Product: Sesamöl-Leinöl-Mischung PL 01, Cannabis Extract Avextra 10/10 Solution

Primary endpoint: Change of symptoms as change of the ESAS-TSDS-rating after 12+/- days in comparison to baseline between the intervention-group and placebo-group.
Endpoint(s): Global Patient’s Assessment (GPA), Absolute and relative change the opioid-dosage (prescribed independently according to standard of care/ freedom of therapy) as morphin-aequivalent-dosing in the course of the trial between the groups (interventional and placebo-group) ), Change in count and defined daily dosage (DDD) of other analgetic drugs (direct or indirect) like NSAID, Glucocorticoids, neuropharmaceutics at the timepoint of capture in comparison to baseline between the groupsbaseline), Symptomchange (change of ESAS-TSDS-rating) at the timepoints of capture in comparison to baseline between the groupsvs. baseline) Change disappetence (timepoints vs. baseline) Change NCCN-Distress-Thermometer (timepoints vs. baseline), Change disappetence (visual analog-scale) at the timepoints of capture in comparison to baseline between the groups, Changeof NCCN-Distress-Thermometer at the timepoint sof capture in comparison to baseline between the groups, Change of pain (numerical rating scale) at the timeppoints of capturte in comparsion to baselin between the groups, Change of quality of sleep (Pittsburgh sleepauality index, PSQI) at the timepoints of capture in comparison to bseline betweent he groups, Change of the result of an Quality-Of-Life-Questionaire (European Organsation for Research and Treatment of Cancer Quality of Life Palliativ, EORTC QLQ-C15 PAL) at the timepoints of capture in comparison to baseline and between the groups, Appearence, frequence and severity of Adverse Events (AE) coded according to Medical Dictionalry for Regulatory Activities (MeDRA) and evaluated follwing NCI Common Terminology Criteria for Adverse Events (CTCAE) and and comparison between the groups, Absolute value and change of plasmaconcentration of C-reacive protein (CRP) in comparison to baseline between the groups (derived from routine samples according to standard-of-care)., Stratified evaluation of the analyses named above, according to kind and stadium of the oncological disease (ICD-10), way of treatment, sex, weight, high-/low-dose and age.

Source: https://euclinicaltrials.eu/ctis-public/view/2024-518917-24-00